EU clinical trial 2025-522215-42-00: Individualized Multiplex Pathophysiological Treatment of Severe Acute Infections (IMPACT)
Sponsor: Copenhagen University Hospital (Hospital/Clinic/Other health care facility). Phase: Therapeutic use (Phase IV). Countries: Denmark (not authorised).
Therapeutic area(s): Diseases [C] - Bacterial Infections and Mycoses [C01]; Diseases [C] - Virus Diseases [C02]
Gender: Female, Male. Age: 18-64 years, 65+ years. Enrolment: 300.
Status: Not authorised. Decision date: 2025-12-08. Results received: No. Last updated: 2025-12-08.

Condition(s): Severe acute infection
Product: Solu-Cortef, pulver og solvens til injektionsvæske, opløsning, Hydrokortison Orion 10 mg tabletter., Acetylcystein SAD koncentrat til infusionsvæske, opløsning, Monofer, injektions- og infusionsvæske, opløsning

Primary endpoint: Days alive and out of hospital at 14 days post-randomization (DAOH-14)
Endpoint(s): Number of participants with one or more serious adverse event within 14 days of randomization, Days alive and out of hospital at 30 days post-randomization, All-cause mortality at 14, 30 and 180 days after inclusion, ICU admission within 14 and 30 days of randomization, Hospital length of stay within 14 and 30 days of admission, Health related quality-of-life at 180 days post-randomization (EQ-5D-5L), Duration of antibiotic therapy within 14 and 30 days of randomization, Escalation of antibiotic therapy within 14 and 30 days of randomization, Days requiring high-flow nasal oxygen therapy, continuous positive airway pressure or non-invasive ventilation within 30 days of randomization, Endotracheal intubation for hypoxia within 30 days of randomization, Initiation of vasoactive medication within 30 days of randomization, Number of participants with elevation of any parameter of liver dysfunction within 30 days of randomization, Blood transfusion within 30 days of randomization, Hemoglobin <6.2 within 30 days of randomization

Source: https://euclinicaltrials.eu/ctis-public/view/2025-522215-42-00